EU clinical trial 2024-513229-22-00: A Phase 2, Open-Label, Multicenter, Cohort Study of Nemvaleukin Alfa (ALKS 4230) Monotherapy and in Combination With Pembrolizumab in Patients With Advanced Cutaneous Melanoma or Advanced Mucosal Melanoma - ARTISTRY-6
Protocol code: ALKS4230-006
Sponsor: Mural Oncology Inc. (Pharmaceutical company). Phase: Therapeutic exploratory (Phase II). Countries: Spain (ended), Italy (ended).
Therapeutic area(s): Diseases [C] - Neoplasms [C04]
Gender: Female, Male. Age: 18-64 years, 65+ years. Enrolment: 53.
Status: Ended. Start date (EU): 2022-04-21. End date (EU): 2025-04-15. Decision date: 2024-10-14. Results received: Yes. Last updated: 2025-04-29.
Decision dates by country: ES: 2024-10-14, IT: 2024-10-28

Condition(s): Advanced cutaneous melanoma and Advanced mucosal melanoma
Product: KEYTRUDA 25 mg/mL concentrate for solution for infusion, NEMVALEUKIN ALFA, NEMVALEUKIN ALFA

Primary endpoint: Centrally-assessed overall response rate (ORR) based on Response Evaluation Criteria in Solid Tumors (RECIST) 1.1 (Cohorts 1 and 2), Investigator-assessed ORR based on RECIST 1.1 (Cohort 3) and Cohort 4
Endpoint(s): Centrally-assessed duration of response (DOR), progression-free survival (PFS), and disease control rate (DCR), and time to response (TTR) based on RECIST 1.1.(Cohorts 1 and 2)., Investigator-assessed DOR, PFS, DCR, and TTR based on RECIST 1.1(Cohort 3 and Cohort 4), Safety and tolerability will be assessed on the basis of treatmentemergent adverse events (TEAEs), vital signs and weight, electrocardiograms (ECGs), and clinical laboratory parameters.

Source: https://euclinicaltrials.eu/ctis-public/view/2024-513229-22-00